EU clinical trial 2024-514554-75-00: A Phase I/Ib Dose Escalation and Cohort Expansion Study of OMX-0407 a Salt-inducible Kinase inhibitor in patients with previously treated unresectable solid tumours
Protocol code: OMX-0407-101
Sponsor: iOmx Therapeutics AG (Pharmaceutical company). Phase: Human Pharmacology (Phase I)- First administration to humans. Countries: Belgium (ended), Spain (ended), France (ended).
Therapeutic area(s): Diseases [C] - Neoplasms [C04]
Gender: Female, Male. Age: 0-17 years, 18-64 years, 65+ years. Enrolment: 224.
Status: Ended. Start date (EU): 2023-03-16. End date (EU): 2026-04-02. Decision date: 2024-09-23. Results received: Yes. Last updated: 2026-03-04.
Decision dates by country: FR: 2025-03-31, BE: 2024-09-23, ES: 2024-09-25

Condition(s): Previously treated unresectable solid tumours

Primary endpoint: Dose escalation phase : Incidence of DLTs attributable to OMX-0407 at each dose level. Cohort expansion phase : ORR. Tumour assessments will be performed at baseline and following every 12 weeks. For cutaneous AS cohort, images will be independently assessed. Responses will be defined according to immune-modified Response Evaluation Criteria in Solid Tumours (iRECIST).

Source: https://euclinicaltrials.eu/ctis-public/view/2024-514554-75-00